EU clinical trial 2023-503904-10-00: A Phase 3 Randomized, Double-blind, Placebo-controlled Study to Evaluate the Efficacy and Safety of Dazodalibep in Participants With Sjögren’s Syndrome With Moderate-to-severe Systemic Disease Activity
Protocol code: HZNP-DAZ-301
Sponsor: Horizon Therapeutics Ireland Designated Activity Company (Pharmaceutical company). Phase: Therapeutic confirmatory (Phase III). Countries: Belgium (ended), Hungary (ended), Croatia (ended), Germany (ended), Greece (ended), Italy (ongoing, recruitment ended), Poland (ended), Portugal (ended), France (ended), Slovenia (ended), Spain (ended), Denmark (ended).
Therapeutic area(s): Phenomena and Processes [G] - Immune system processes [G12]; Phenomena and Processes [G] - Immune System Phenomena [G13]; Diseases [C] - Immune System Diseases [C20]
Gender: Female, Male. Age: 18-64 years, 65+ years. Enrolment: 231.
Start date (EU): 2024-06-07. Decision date: 2024-04-29. Results received: No. Last updated: 2026-05-20.
Decision dates by country: DK: 2024-05-28, SI: 2024-04-30, HU: 2024-05-06, HR: 2024-04-30, DE: 2024-05-02, PT: 2024-05-27, PL: 2024-05-06, FR: 2024-05-02, ES: 2024-05-03, GR: 2024-05-08, BE: 2024-04-29, IT: 2024-04-30

Condition(s): Sjögren’s Syndrome With Moderate-to-severe Systemic Disease Activity
Product: Dazodalibep, The placebo is formulated as sterile liquid intended for intravenous infusion following dilution in normal saline. The placebo is aseptically filled into 6R glass vials( the nominal volume in each vial is 5.0 mL) and 20R glass vials (the nominal volume in each vial is 15.0 mL) , stoppered with a Flurotec-coated elastomeric stopper, and sealed with an aluminum overseal.

Primary endpoint: Change from baseline in ESSDAI score at Week 48
Endpoint(s): Change from baseline in DASPRI dryness domain score at Week 48 (Plan A), Change from baseline in EULAR SS Patient Reported Index (ESSPRI) dryness domain score at Week 48 (Plan B), Change from baseline in tender and swollen joint counts at Week 48 (Plan A and Plan B), Change from baseline in PROMIS-Fatigue SF-10a at Week 48 (Plan A and Plan B), Change from baseline in ESSDAI score at Week 12 and Week 24 (Plan A and Plan B), Change from baseline in DASPRI total score at Week 48 (Plan A), Change from baseline in ESSPRI total score at Week 48 (Plan B), Change from baseline in total stimulated salivary flow at Week 48 (Plan A and Plan B), Plasma concentration of dazodalibep, Incidence of treatmentemergent adverse events (TEAEs), treatmentemergent serious adverse events, (TESAEs), and adverse events of special interest (AESIs)., Proportion of participants achieving ESSDAI[5] response, defined as a decrease of at least 5 points from baseline in the ESSDAI at Week 48 without premature discontinuation from treatment and without receiving rescue or potentially confounding therapy (Plan A and Plan B).

Source: https://euclinicaltrials.eu/ctis-public/view/2023-503904-10-00